EU clinical trial 2022-502047-35-00: Controlled Study of Immunogenicity and Safety of the Investigational vYF Candidate Vaccine in Comparison to Stamaril® in Adults
Protocol code: VYF03
Sponsor: Sanofi Pasteur (Pharmaceutical company). Phase: Therapeutic exploratory (Phase II). Countries: Germany (ongoing, recruitment ended), Finland (ongoing, recruitment ended), Spain (ongoing, recruitment ended), France (ongoing, recruitment ended).
Therapeutic area(s): Diseases [C] - Virus Diseases [C02]
Gender: Female, Male. Age: 18-64 years. Enrolment: 570.
Status: Ongoing, recruitment ended. Start date (EU): 2021-10-07. Decision date: 2023-02-28. Results received: No. Last updated: 2026-08-06.
Decision dates by country: FR: 2023-02-28, DE: 2023-03-02, ES: 2023-03-03, FI: 2023-03-02

Condition(s): Yellow fever
Product: vYF vaccine, STAMARIL, poudre et solvant pour suspension injectable en seringue préremplie. Vaccin de la fièvre jaune (Vivant).

Primary endpoint: Percentage of participants in EU with seroconversion to YF virus in YF-naïve population. Seroconversion is defined as a 4-fold increase in neutralizing antibody (NAb) titers as compared to the pre-vaccination value.
Endpoint(s): Percentage of participants in EU with seroconversion to YF virus in YF-naïve population. Seroconversion is defined as a 4-fold increase in NAb titers: i) as compared to the Day 01 titers at each time point up to Month 6; ii) as compared to the last planned previous time point from Y1 onwards., Percentage of participants in EU and in Asia with seroprotection to YF virus. Seroprotection is defined as NAb titers ≥ 10 (1/dil) at the corresponding timepoint., Geometric Mean Titers (GMTs) of neutralizing antibodies against YF virus in all participants in EU and in Asia. Antibody titers are expressed as geometric mean titers., Geometric Mean Titers Ratio (GMTRs) of neutralizing antibodies against YF virus in all participants in EU and in Asia. GMTRs Day 11/Day 01 (subset only), Day 29/Day 01, Month 6/Day 01, Year 1/Month 6, Year 2/Year 1, Year 3/Year 2, Year 4/Year 3, Year 5/Year 4., Number of participants in EU and in Asia with immediate adverse avents. Immediate adverse events are any unsolicited systemic adverse events reported in the 30 minutes after vaccination, Number of participants in EU and in Asia with solicited injection site reactions. Solicited injection site reactions include injection site pain, erythema and swelling., Number of participants in EU and in Asia with solicited systemic reactions. Solicited systemic reactions include fever, headache, malaise and myalgia., Number of participants in EU and in Asia with unsolicited adverse avents (AEs). Unsolicited (spontaneously reported) AEs, not fulfilling criteria for solicited adverse reactions., Number of participants in EU and in Asia with serious adverse avents (SAEs) and adverse events of special interest (AESIs). SAEs and AESIs., Number of participants in EU and in Asia with related SAEs and death.

Source: https://euclinicaltrials.eu/ctis-public/view/2022-502047-35-00